EU clinical trial 2024-519493-39-00: A Phase 3, Randomized, Open-label, Multicenter Study Evaluating the Efficacy and Safety of TAR-210 Erdafitinib Intravesical Delivery System Versus Investigator’s Choice of Intravesical Chemotherapy in Participants with High-risk Non-muscle-invasive Bladder Cancer with Susceptible FGFR Alterations Who Had Received Intravesical Bacillus Calmette-Guérin (BCG)
Protocol code: 42756493BLC3005
Sponsor: Janssen Cilag International (Pharmaceutical company). Phase: Therapeutic confirmatory (Phase III). Countries: France (ongoing, recruiting), Germany (ongoing, recruiting), Spain (ongoing, recruiting), Netherlands (ongoing, recruiting), Italy (ongoing, recruiting), Belgium (ongoing, recruiting), Greece (ongoing, recruiting).
Therapeutic area(s): Diseases [C] - Neoplasms [C04]
Gender: Female, Male. Age: 18-64 years, 65+ years. Enrolment: 90.
Status: Ongoing, recruiting. Start date (EU): 2025-12-09. Decision date: 2025-11-03. Results received: No. Last updated: 2026-06-04.
Decision dates by country: GR: 2025-11-04, ES: 2025-11-05, IT: 2025-11-07, FR: 2025-11-10, DE: 2025-11-04, NL: 2025-11-06, BE: 2025-11-03

Condition(s): High-risk Non-muscle-invasive Bladder Cancer with Susceptible FGFR Alterations
Product: JNJ-42756493, MITOMYCIN, GEMCITABINE

Primary endpoint: DFS

Source: https://euclinicaltrials.eu/ctis-public/view/2024-519493-39-00